EU clinical trial 2024-515732-68-00: A Study to Evaluate ALN-HTT02 in Adult Patients with Huntington’s Disease
Protocol code: ALN-HTT02-001
Sponsor: Alnylam Pharmaceuticals Inc. (Pharmaceutical company). Phase: Human Pharmacology (Phase I)- First administration to humans. Countries: Germany (ongoing, recruiting).
Therapeutic area(s): Diseases [C] - Nervous System Diseases [C10]
Gender: Female, Male. Age: 18-64 years, 65+ years. Enrolment: 20.
Status: Ongoing, recruiting. Start date (EU): 2025-03-07. Decision date: 2024-12-23. Results received: No. Last updated: 2026-03-19.

Condition(s): Huntington’s disease

Source: https://euclinicaltrials.eu/ctis-public/view/2024-515732-68-00